EU clinical trial 2024-512915-33-00: A Randomized Open-Label Phase 3 Study of XL092 + Atezolizumab vs Regorafenib in Subjects with Metastatic Colorectal Cancer
Protocol code: XL092-303
Sponsor: Exelixis Inc. (Pharmaceutical company). Phase: Therapeutic confirmatory (Phase III). Countries: Hungary (ongoing, recruitment ended), Germany (ongoing, recruitment ended), Portugal (ongoing, recruitment ended), Spain (ongoing, recruitment ended), Poland (ongoing, recruitment ended), Belgium (ongoing, recruitment ended), France (ongoing, recruitment ended).
Therapeutic area(s): Diseases [C] - Neoplasms [C04]
Gender: Female, Male. Age: 18-64 years, 65+ years. Enrolment: 328.
Status: Ongoing, recruitment ended. Start date (EU): 2022-12-22. Decision date: 2024-07-31. Results received: No. Last updated: 2026-02-23.
Decision dates by country: FR: 2024-09-20, ES: 2024-07-31, PT: 2024-08-06, HU: 2024-07-31, DE: 2024-08-08, BE: 2024-07-31, PL: 2024-08-04

Condition(s): Metastatic Colorectal Cancer
Product: XL092, XL092, Tecentriq 1 200 mg concentrate for solution for infusion, XL092, Stivarga 40 mg film-coated tablets

Primary endpoint: Overall Survival
Endpoint(s): PFS as assessed by the investigator per RECIST 1.1, ORR as assessed by the investigator per RECIST 1.1, DOR as assessed by the investigator per RECIST 1.1, Incidence and severity of Es, SAEs and adverse events of special interest (AESIs), Plasma concentration of XL092 given in combination with atezolizumab, serum concentration of atezolizumab given in combination with XL092, the incidence of antidrug antibody (ADA) response against atezolizumab given in combination with XL092.

Source: https://euclinicaltrials.eu/ctis-public/view/2024-512915-33-00